EU clinical trial 2023-505543-39-00: A Phase III, Multicentre, Randomised, Double-blind, Chronic-dosing, Parallel-group, Placebo-controlled Study to Evaluate the Efficacy and Safety of Tozorakimab in Participants with Symptomatic Chronic Obstructive Pulmonary Disease (COPD) with a History of COPD Exacerbations (MIRANDA)
Protocol code: D9180C00012
Sponsor: Astrazeneca AB (Pharmaceutical company). Phase: Therapeutic confirmatory (Phase III). Countries: Greece (ended), Denmark (ended), Netherlands (ended), Poland (ended), Belgium (ended), France (ended), Hungary (ended), Spain (ended), Germany (ended), Italy (ended), Ireland (ended), Bulgaria (ended).
Therapeutic area(s): Diseases [C] - Respiratory Tract Diseases [C08]
Gender: Female, Male. Age: 18-64 years, 65+ years. Enrolment: 480.
Status: Ended. Start date (EU): 2024-02-12. End date (EU): 2026-05-20. End date: 2026-05-22. Decision date: 2024-02-05. Results received: No. Last updated: 2026-06-17.
Decision dates by country: IT: 2024-02-07, HU: 2024-02-08, DE: 2024-02-09, BE: 2024-02-07, DK: 2024-02-05, GR: 2024-02-12, FR: 2024-03-29, NL: 2024-02-05, BG: 2024-02-12, IE: 2024-02-09, PL: 2024-02-09, ES: 2024-02-06

Condition(s): Chronic Obstructive Pulmonary Disease (COPD)
Product: Tozorakimab-placebo, Tozorakimab, SALBUTAMOL

Primary endpoint: Annualized rate of moderate to severe COPD exacerbations in participants who are former smokers.
Endpoint(s): Annualized rate of moderate to severe COPD exacerbations in former or current smokers, Change from baseline in SGRQ total score in former smokers, Change from baseline in SGRQ total score in former or current smokers, Annualized rate of severe COPD exacerbations in former smokers, Annualized rate of severe COPD exacerbations in former or current smokers, Change from baseline in E-RS:COPD total score in former smokers, Change from baseline in E-RS:COPD total score in former or current smokers, Change from baseline in pre-bronchodilator, pre dose trough FEV1 (mL) in former smokers, Change from baseline in pre-bronchodilator, pre dose trough FEV1 (mL) in former or current smokers, Time to first moderate to severe COPD exacerbation, Time to first severe COPD exacerbation, Change from baseline in CAT total score, Proportion of participants achieving MCID in CAT score, Proportion of participants achieving MCID in SGRQ total score, Proportion of participants achieving MCID in E-RS:COPD total score, Annualized rate of healthcare resource utilization, Change from baseline in rescue medication, Trough serum concentrations of tozorakimab, Presence of anti-drug antibodies, Time to death, Safety and tolerability, Change from baseline in post-bronchodilator FEV1 (mL) in former smokers, Change from baseline in post-bronchodilator FEV1 (mL) in former or current smokers, Annualised rate of COPD exacerbations requiring hospitalisations and/or Emergency Room /Emergency Department visits in former smokers, Annualised rate of COPD exacerbations requiring hospitalisations and/or Emergency Room /Emergency Department visits in former or current smokers

Source: https://euclinicaltrials.eu/ctis-public/view/2023-505543-39-00